EU clinical trial 2024-511517-38-00: A prospective randomized, single-blind, multicenter phase II study comparing two methods of cardioplegia in cardiac surgery due to congenital heart malformation in children: Custodiol-N versus Custodiol (CL-N-CP-Paed-II/09/19)
Protocol code: CL-N-CP-Paed
Sponsor: Dr. Franz Koehler Chemie GmbH (Pharmaceutical company). Phase: Therapeutic exploratory (Phase II). Countries: Germany (temporarily halted).
Therapeutic area(s): Diseases [C] - Cardiovascular Diseases [C14]
Gender: Female, Male. Age: 0-17 years. Enrolment: 100.
Status: Temporarily halted. Start date (EU): 2024-11-05. Decision date: 2024-08-16. Results received: No. Last updated: 2025-03-28.

Condition(s): congenital heart malformation inchildren
Product: CUSTODIOL® - Perfusionslösung, Custodiol-N

Primary endpoint: The main purpose of the clinical trial is safety assessment regarding • Continuous adverse events (AEs) reporting up to 30 days postoperatively • Myocardial protection in surviving patients, as assessed by quantification of perioperative CK-MB levels (U/l) until day 7 postoperatively (Area under the curve)
Endpoint(s): Description of hemodynamics (incl. vitals signs, blood gas parameters, catecholamine support, milrinone support), Description of echo, Description of cardiac injury (incl. creatinine kinase, troponin), Hospital/ ICU stay (readmissions, duration)/ Death, Description of surgery (incl. number of intraoperative administrations of cardioplegia), Description of 12-Lead-ECG, Description of cardiac arrhythmias (incl. need for pacemaker)

Source: https://euclinicaltrials.eu/ctis-public/view/2024-511517-38-00